EU clinical trial 2023-510007-22-00: An Open-label Multicenter Study to Evaluate the Pharmacokinetics, Pharmacodynamics, and Safety of Inebilizumab in Pediatric Subjects with Neuromyelitis Optica Spectrum Disorder
Protocol code: VIB0551.P2.S2.NMO
Sponsor: Horizon Therapeutics Ireland Designated Activity Company (Pharmaceutical company). Phase: Therapeutic exploratory (Phase II). Countries: Spain (authorised, recruiting), Poland (ongoing, recruiting), Sweden (ongoing, recruiting), Netherlands (authorised, recruiting), France (ongoing, recruiting).
Therapeutic area(s): Diseases [C] - Nervous System Diseases [C10]
Gender: Female, Male. Age: 0-17 years. Enrolment: 5.
Start date (EU): 2022-07-20. Decision date: 2024-05-14. Results received: No. Last updated: 2026-05-29.
Decision dates by country: PL: 2024-05-20, SE: 2024-05-14, FR: 2024-05-17, ES: 2024-05-14, NL: 2024-05-14

Condition(s): Neuromyelitis optica spectrum disorder (NMOSD; also known as Devic's syndrome and previously known as neuromyelitis optica [NMO])
Product: INEBILIZUMAB

Primary endpoint: 1. PK parameters, including maximum observed concentration (Cmax), area under the concentration-time curve from time 0 to 14 days post dose (AUC0-14d) and from time 0 extrapolated to infinity (AUC0-inf), systemic clearance, terminal elimination half-life (t½), and volume of distribution at steady state (Vss), 2. CD20-positive B-cell counts on Days 1, 8, 15, 29, 57, 85, 113, 155, and 197, 3. Safety and tolerability assessments, including incidence of adverse events (AEs)/serious adverse events (SAEs)/adverse events of special interest (AESIs) and changes in laboratory parameters and vital signs
Endpoint(s): 1. Disease activity endpoints include: − Time to first relapse − Proportion of relapse-free subjects − Annualized relapse rate, 2. HRQoL endpoints include: − Change in Euro Quality of Life-5 Dimension Youth (EQ-5D-Y) score − Change in Pediatric Quality of Life Inventory (PedsQL), 3. Change in visual acuity, 4. Change in EDSS, 5. Presence of anti-drug antibody (ADA)

Source: https://euclinicaltrials.eu/ctis-public/view/2023-510007-22-00